EU clinical trial 2023-503411-15-00: A randomized trial investigating the superiority of TDM-optimized teicoplanin dosing versus standard of care
Protocol code: 113998
Sponsor: Stichting Radboud University Medical Center (Hospital/Clinic/Other health care facility). Phase: Therapeutic use (Phase IV). Countries: Netherlands (ended).
Therapeutic area(s): Diseases [C] - Bacterial Infections and Mycoses [C01]
Gender: Female, Male. Age: 18-64 years, 65+ years. Enrolment: 74.
Status: Ended. Start date (EU): 2023-08-17. End date (EU): 2026-02-20. Decision date: 2023-06-01. Results received: No. Last updated: 2025-07-01.
Decision dates by country: NL: 2023-07-20

Condition(s): Sepsis
Product: Teicoplanin Hikma 400 mg Powder for solution for Injection/infusion or oral solution

Primary endpoint: • The difference in fraction of patients reaching pharmacokinetic target attainment of unbound teicoplanin concentrations at 5 days after start of treatment of the study group versus the control group.
Endpoint(s): • Time until reaching target attainment., • Incidence of clinical failure at day 30., • Total number of days in hospital, • Incidence of AKI during teicoplanin treatment

Source: https://euclinicaltrials.eu/ctis-public/view/2023-503411-15-00